EU clinical trial 2024-517358-86-00: MR-HYPERPOLARISATION SCANNING WITH HYPERPOLARISED PYRUVATE (13C) IN PANCREATIC CANCER PATIENTS – A FEASIBILITY STUDY
Sponsor: Aarhus Universitet (Educational Institution). Phase: Therapeutic exploratory (Phase II). Countries: Denmark (ongoing, recruiting).
Therapeutic area(s): Analytical, Diagnostic and Therapeutic Techniques and Equipment [E] - Investigative Techniques [E05]
Gender: Female, Male. Age: 18-64 years, 65+ years. Enrolment: 16.
Status: Ongoing, recruiting. Start date (EU): 2024-09-13. Decision date: 2024-09-13. Results received: No. Last updated: 2025-09-25.

Condition(s): Pancreatic Cancer
Product: Hyperpolarized [1-13C]pyruvate

Primary endpoint: C13-Pyruvate spectroscopy imaging generates spectroscopic parameters (quantitative data for lactate, pyruvate, arginine and HCO3-). These will be projected 07-07-22 Projektbeskrivelse: MR-hyperpolarization 8. Version. Page 25 into a high-resolution anatomical image. The quantitative numerical data will be given as ratios, e.g. lactate/pyruvate-ratio, which gives us the possibility to perform comparisons between non-tumor vs. tumor tissue and pre-chemo vs. post-chemo.

Source: https://euclinicaltrials.eu/ctis-public/view/2024-517358-86-00